EU clinical trial 2024-512721-89-00: A multicentre, prospective, open-label study with [68Ga]Ga-ABY-025 PET-imaging to characterize HER2-expression and explore the therapy-predictive value for HER2-antibody drug conjugates in patients with metastatic breast cancer (HER2-Ex PET)
Protocol code: HER2-Ex PET
Sponsor: Karolinska University Hospital (Hospital/Clinic/Other health care facility). Phase: Therapeutic exploratory (Phase II). Countries: Sweden (authorised, recruitment pending).
Therapeutic area(s): Analytical, Diagnostic and Therapeutic Techniques and Equipment [E] - Diagnosis [E01]; Diseases [C] - Neoplasms [C04]
Gender: Female. Age: 18-64 years, 65+ years. Enrolment: 70.
Status: Authorised, recruitment pending. Decision date: 2024-12-23. Results received: No. Last updated: 2026-01-08.

Condition(s): Breast Cancer
Product: Enhertu 100 mg powder for concentrate for solution for infusion

Primary endpoint: The mean SUVmax in up to five ABY-025 avid lesions at the baseline investigation will be used to assess the primary objective of the study, i.e. to relate HER2-status on PET to the response according to RECIST v1.1 after 3-4 treatment cycles with T-DXd.
Endpoint(s): Changes (deltaSUVmax) in HER2-status in up to five target lesions according to [68Ga ]Ga-ABY-025 uptake prior to and after 3-4 cycles of treatment with T-DXd., Correlation between HER2-expressing total tumor volume (HER2-TTV; defined as proportion of ABY-025 avid lesions in relation to the total tumor volume (TTV, lesions ≥10 mm) defined on CT) at baseline and ORR, Progression Free and Overall Survival after treatment with T-DXd, Change in patient reported Health-Related Quality of Life (HR-QoL) as measured by the EQ-5D-5L questionnaire from baseline to the first treatment evaluation

Source: https://euclinicaltrials.eu/ctis-public/view/2024-512721-89-00